EU clinical trial 2023-509405-77-00: C4221015 - AN OPEN-LABEL, MULTICENTER, RANDOMIZED PHASE 3 STUDY OF FIRST LINE ENCORAFENIB PLUS CETUXIMAB WITH OR WITHOUT CHEMOTHERAPY VERSUS STANDARD OF CARE THERAPY WITH A SAFETY LEAD-IN OF ENCORAFENIB AND CETUXIMAB PLUS CHEMOTHERAPY IN PARTICIPANTS WITH METASTATIC BRAF V600E MUTANT COLORECTAL CANCER
Protocol code: C4221015
Sponsor: Pfizer Inc. (Pharmaceutical company). Phase: Therapeutic confirmatory (Phase III). Countries: Germany (ongoing, recruitment ended), Finland (ongoing, recruitment ended), Spain (ongoing, recruitment ended), Belgium (ongoing, recruitment ended), Norway (ongoing, recruitment ended), Czechia (ongoing, recruitment ended), Denmark (ongoing, recruitment ended), Slovakia (ended), Italy (ongoing, recruitment ended), Sweden (ongoing, recruitment ended), Poland (ongoing, recruitment ended), Bulgaria (ongoing, recruitment ended), Netherlands (ongoing, recruitment ended).
Therapeutic area(s): Diseases [C] - Neoplasms [C04]
Gender: Female, Male. Age: 0-17 years, 18-64 years, 65+ years. Enrolment: 300.
Start date (EU): 2021-02-16. Decision date: 2024-04-10. Results received: No. Last updated: 2026-06-24.
Decision dates by country: DK: 2024-05-07, SK: 2024-05-07, DE: 2024-04-12, NL: 2024-05-07, FI: 2024-04-11, NO: 2024-04-25, ES: 2024-04-12, BG: 2024-05-07, CZ: 2024-04-11, SE: 2024-05-07, IT: 2024-05-07, PL: 2024-05-07, BE: 2024-04-17

Condition(s): Colorectal cancer (BRAF V600E-mutant mCRC)
Product: Calcium Folinate 10 mg/ml Injection, OXALIPLATIN, BEVACIZUMAB, Capecitabine, CETUXIMAB, Irinotecan hydrochloride 20 mg/ml concentrate for solution for infusion, CAMPTO 20 mg/mL concentrate for solution for infusion, Oxaliplatin 5mg/ml concentrate for Solution for Infusion, Bevacizumab, IRINOTECAN, Oxaliplatin 5mg/ml concentrate for solution for infusion, CAPECITABINE, FLUOROURACIL, ENCORAFENIB, CAPECITABINE, CAMPTO 20 mg/mL concentrate for solution for infusion, CALCIUM FOLINATE, Cetuximab, Fluorouracil 50 mg/ml Solution for Injection or Infusion

Primary endpoint: Safety Lead-In: Incidence of dose-limiting toxicities (DLTs), Phase 3: • PFS by blinded independent central review (BICR), defined as the time from the date of randomization to the earliest documented disease progression per RECIST v1.1, or death due to any cause • ORR by BICR, Cohort 3: • ORR by BICR
Endpoint(s): Safety Lead-In: Incidence and severity of adverse events (AEs) graded according to the National Cancer Institute (NCI ) Common Terminology Criteria for Adverse Events (CTCAE) v4.03 and changes in clinical laboratory parameters, vital signs and electrocardiograms (ECGs), Safety Lead-In: Incidence of dose interruptions, dose modifications and discontinuations due to AEs, Safety Lead-In: ORR by Investigator, defined as the proportion of participants who have achieved a confirmed best overall response (BOR) (complete response [CR] or partial response [PR]) per Response Evaluation Criteria in Solid Tumors (RECIST) v1.1, Safety Lead-In: Duration of response (DOR) by Investigator, defined as the time from the date of first radiographic evidence of response (CR or PR) to the earliest documented disease progression per RECIST v1.1, or death due to any cause, Safety Lead-In: Progression-free survival (PFS) by Investigator, defined as the time from the first dose to the earliest documented disease progression per RECIST v1.1, or death due to any cause, Safety Lead-In: Time to response (TTR) by Investigator, defined as the time from first dose to first radiographic evidence of response (CR or PR) per RECIST v1.1, Safety Lead-In: Overall survival (OS) defined as the time from the first dose to death due to any cause, Safety Lead-In: PK parameters of encorafenib, irinotecan, oxaliplatin and relevant metabolites, Safety Lead-In: Changes in exposures of irinotecan and its metabolite (SN-38) on Cycle 1 Day 15 compared to Cycle 1 Day 1 in Cohort 1 (EC + FOLFIRI), Safety Lead-In: Changes in exposures of oxaliplatin on Cycle 1 Day 15 compared to Cycle 1 Day 1 in Cohort 2 (EC + mFOLFOX6), Phase 3: - OS, defined as the time from the date of randomization to death due to any cause, Phase 3: - ORR by Investigator, Phase 3: - ORR by BICR (Arm A vs Control Arm, Arm A vs Arm B), Phase 3: - DOR by BICR and by Investigator, Phase 3: - PFS by BICR (Arm A vs Control Arm, Arm A vs Arm B), Phase 3: - OS (Arm A vs Control Arm, Arm A vs Arm B), Phase 3: - PFS by Investigator - TTR (by BICR and by Investigator), defined as the time from the date of randomization to first radiographic evidence of response (CR or PR) per RECIST v1.1, Phase 3: -PFS2, defined as the time from the date of randomization to the date of discontinuation of next-line treatment after first objective PD by investigator assessment, the second objective disease progression, or death from any cause, whichever occurs first, Phase 3:- Incidence and severity of AEs graded according to the NCI CTCAE v4.03 and changes in clinical laboratory parameters, vital signs, and ECGs, Phase 3: - PRO scores as measured by the European Organisation for Research and Treatment of Cancer Quality of Life Questionnaire for Cancer Patients – 30 Item Core Questionnaire (EORTC QLQ-C30), EuroQol-5D-5L (EQ-5D-5L), and anchoring instruments Patient Global Impression of Severity (PGIS) and Patient Global Impression of Change (PGIC)., Phase 3:- Trough plasma concentrations of encorafenib and the metabolite LHY746 in Arm A and Arm B, Phase 3: - PK parameters of encorafenib and its metabolite LHY746, Phase 3:- Summarize MSI-status as determined by retrospective central testing of baseline tumor tissue, Phase 3: - ctDNA levels and BRAF V600 variant allele fraction (VAF) from ctDNA analysis of plasma samples collected at baseline and on treatment, Cohort 3: -PFS by BICR, defined as the time from the date of randomization to the earliest documented disease progression per RECIST v1.1, or death due to any cause, Cohort 3: -ORR by Investigator, Cohort 3: -DOR by BICR and by Investigator, defined as the time from the date of first radiographic evidence of response (CR or PR) to the earliest documented disease progression per RECIST v1.1, or death due to any cause, Cohort 3:- PFS by Investigator, defined as the time from the date of randomization to the earliest documented disease progression per RECIST v1.1, or death due to any cause, Cohort 3:--OS, defined as the time from the date of randomization to death due to any cause, Cohort 3:- TTR (by BICR and by Investigator), defined as the time from the date of randomization to first radiographic evidence of response (CR or PR) per RECIST v1.1, Cohort 3:- Incidence and severity of AEs graded according to the NCI CTCAE v4.03 and changes in clinical laboratory parameters, vital signs, and ECGs, Cohort 3:- PRO scores as measured by the EORTC QLQ-C30, EQ-5D-5L, and anchoring instruments PGIS and PGIC, Cohort 3:Trough plasma concentrations of encorafenib and the metabolite LHY746 in Cohort 3 Arm D, Cohort 3:- Summarize MSI-status as determined by retrospective central testing of baseline tumor tissue, Cohort 3:- ctDNA levels and BRAF V600 VAF from ctDNA analysis of plasma samples collected at baseline and on treatment

Source: https://euclinicaltrials.eu/ctis-public/view/2023-509405-77-00